EU clinical trial 2024-518705-18-00: CROSS-OVER ANALYSIS OF THE CONTROL OF RISK FACTORS AND ANTIAGGREGATION WITH POLIPILL (POLICROSS TRIAL)
Sponsor: Fundacion Epic (Educational Institution). Phase: Phase III and phase IV (Integrated). Countries: Spain (authorised, recruiting).
Therapeutic area(s): Diseases [C] - Cardiovascular Diseases [C14]
Gender: Female, Male. Age: 18-64 years, 65+ years. Enrolment: 88.
Status: Authorised, recruiting. Start date (EU): 2026-03-27. Decision date: 2024-11-04. Results received: No. Last updated: 2024-11-04.

Condition(s): Degree of control coronary risk factors and platelet aggregation
Product: Trinomia 100 mg/20 mg/5 mg cápsulas duras., Trinomia 100 mg/40 mg/5 mg cápsulas duras., Adiro 100 mg comprimidos gastrorresistentes EFG, Trinomia 100 mg/20 mg/2,5 mg cápsulas duras., Cardyl 40 mg comprimidos recubiertos con película, Acovil 10 mg comprimidos, Cardyl 20 mg comprimidos recubiertos con película, Trinomia 100 mg/20 mg/10 mg cápsulas duras., Trinomia 100 mg/40 mg/2,5 mg cápsulas duras., Trinomia 100 mg/40 mg/10 mg cápsulas duras., Acovil 5 mg comprimidos, Acovil 2,5 mg comprimidos

Primary endpoint: Systolic blood pressure level. LDL cholesterol.
Endpoint(s): Systolic blood pressure level. LDL cholesterol.

Source: https://euclinicaltrials.eu/ctis-public/view/2024-518705-18-00